EU clinical trial 2024-516548-25-00: A clinical study of MK-2420 in healthy people (MK-2420-002)
Protocol code: MK-2420-002
Sponsor: Merck Sharp & Dohme LLC (Pharmaceutical company). Phase: Human Pharmacology (Phase I)- Other. Countries: Belgium (ended).
Therapeutic area(s): Diseases [C] - Immune System Diseases [C20]
Gender: Female, Male. Age: 18-64 years. Enrolment: 40.
Status: Ended. Start date (EU): 2025-03-12. End date (EU): 2025-11-13. End date: 2025-11-14. Decision date: 2025-02-27. Results received: No. Last updated: 2025-09-02.

Condition(s): Rheumatoid arthritis

Source: https://euclinicaltrials.eu/ctis-public/view/2024-516548-25-00